EU clinical trial 2026-525185-21-00: IKF-099/D-FLOT-TNT Total Neoadjuvant Treatment with preoperative FLOT/Durvalumab plus postoperative Durvalumab for Resectable Gastroesophageal Adenocarcinoma
Protocol code: IKF-099/D-FLOT-TNT
Sponsor: Frankfurter Institut Fuer Klinische Krebsforschung IKF GmbH (Pharmaceutical company). Phase: Therapeutic exploratory (Phase II). Countries: Germany (authorised, recruitment pending), Spain (authorised, recruitment pending).
Therapeutic area(s): Diseases [C] - Digestive System Diseases [C06]
Gender: Female, Male. Age: 18-64 years, 65+ years. Enrolment: 91.
Status: Authorised, recruitment pending. Decision date: 2026-07-23. Results received: No. Last updated: 2026-07-27.
Decision dates by country: DE: 2026-07-23, ES: 2026-07-27

Condition(s): Gastroesophageal Adenocarcinoma
Product: 5-FU medac 50 mg/ml, Injektionslösung, Calcium Folinate 10 mg/ml solution for injection, Oxaliplatin 5 mg/ml concentrate for solution for infusion, IMFINZI 50 mg/mL concentrate for solution for infusion, Docetaxel Accord 20 mg/1 ml concentrate for solution for infusion

Primary endpoint: Pathological complete response (pCR) rate as assessed locally, corresponding to the ypT0N0M0 stage category. pCR is defined as the proportion of patients with pathological complete remission in the post-surgery specimen, meaning complete absence of viable tumor cells in the primary tumor and lymph nodes and no evidence of metastatic disease upon pathological examination.
Endpoint(s): Event-free survival plus EFS-rate at 1 and 2 years,defined as the time from enrollment until the date of one of the following events: progression acc. RECIST 1.1 that precludes surgery or requires non-protocol therapy during the neoadjuvant period; progression acc. RECIST 1.1/recurrence during the adjuvant period;non-RECIST progression that precludes surgery/requires non-protocol therapy during the neoadjuvant period/discovered during surgery;progression/recurrence(biopsy)post-surgery or death, Rate of patients who undergo surgery (with or without resection)o surgery (with or without resection), R0 resection rate, defined as proportion of patients in whom the surgical margin is microscopically negative for residual tumor, Assessment of postoperative ypTNM stage, Overall survival (OS) plus OS-rate at 2 years, defined as time from enrollment to date of death due to any cause. Patients without an event at the time of data cut-off will be censored at the last known date alive., Assessment of safety of the treatment as determined by the incidence, type, causality, frequency, timing and severity of adverse events using NCI CTCAE 6.0, Perioperative morbidity (Clavien-Dindo classification) and mortality, Number of cycles and cumulative dose of applied FLOT and durvalumab, QoL assessed using the EORTC QLQ-C30 questionnaire, Exploratory endpoints: Exploratory analyses of efficacy endpoints by PD-L1 expression status, including the primary endpoint (pCR) and selected secondary endpoints (e.g. EFS and OS), presented descriptively without formal hypothesis testing.

Source: https://euclinicaltrials.eu/ctis-public/view/2026-525185-21-00